EU clinical trial 2025-523152-31-00: Is magnesium sulfate an alternative with an analgesic and safety profile equivalent to dexmedetomidine as an adjuvant to ropivacaine in erector block in mastectomy?
Protocol code: MAGDEX-MAS
Sponsor: Fundacion Para El Fomento De La Investigacion Sanitaria Y Biomedica De La Comunitat Valenciana (Patient organisation/association). Phase: Therapeutic use (Phase IV). Countries: Spain (ongoing, recruiting).
Therapeutic area(s): Diseases [C] - Neoplasms [C04]
Gender: Female, Male. Age: 18-64 years, 65+ years. Enrolment: 62.
Status: Ongoing, recruiting. Start date (EU): 2026-01-26. Decision date: 2025-11-03. Results received: No. Last updated: 2026-04-28.

Condition(s): Breast cancer
Product: DEXMEDETOMIDINE, MAGNESIUM SULFATE, Ropivacaína B. Braun 10 mg/ml solución inyectable EFG

Primary endpoint: Time in minutes between recovery from general anesthesia and the moment the patient requests the first rescue analgesia
Endpoint(s): total amount of rescue analgesic consumed in the postoperative period during the first 24 hours., Pain level using the validated Visual Analog Scale (VAS) (0 = no pain, 10 = maximum imaginable pain). VAS scores will be recorded at time 0, which is when the patient arrives at the PACU, and subsequently at 2, 4, 8, 10, and 24 hours., heart rate (HR) and mean arterial pressure (MAP), incidence of adverse effects such as nausea, vomiting, bradycardia (HR < 60 bpm), hypotension (SBP < 90 mmHg or < 20% of baseline), respiratory depression, pruritus, and any complications related to the block (e.g., vascular puncture, nerve damage, pneumothorax, local anesthetic toxicity)., Patient satisfaction with postoperative pain management will be assessed using a satisfaction scale of 0 to 100 points (0 = Very dissatisfied with the analgesia provided by the treatment and 100 = totally satisfied with the analgesia provided by the treatment).

Source: https://euclinicaltrials.eu/ctis-public/view/2025-523152-31-00